EU clinical trial 2024-519525-38-00: EASi-HF Reduced – A Phase III double-blind, randomised, parallel-group superiority trial to evaluate efficacy and safety of the combined use of oral vicadrostat (BI 690517) and empagliflozin compared with placebo and empagliflozin in participants with symptomatic chronic heart failure (HF: NYHA II-IV) and left ventricular ejection fraction (LVEF) < 40%
Protocol code: 1378-0018
Sponsor: Boehringer Ingelheim International GmbH (Pharmaceutical company). Phase: Therapeutic confirmatory (Phase III). Countries: Hungary (ongoing, recruiting), Slovakia (ongoing, recruiting), Czechia (ongoing, recruiting), Belgium (ongoing, recruiting), Italy (ongoing, recruiting), Bulgaria (ongoing, recruiting), Poland (ongoing, recruiting), Romania (ongoing, recruiting), Germany (ongoing, recruiting), Denmark (ongoing, recruiting), Spain (ongoing, recruiting), Netherlands (ongoing, recruiting).
Therapeutic area(s): Diseases [C] - Cardiovascular Diseases [C14]
Gender: Female, Male. Age: 18-64 years, 65+ years. Enrolment: 1641.
Status: Ongoing, recruiting. Start date (EU): 2025-08-22. Decision date: 2025-07-18. Results received: No. Last updated: 2026-08-03.
Decision dates by country: DE: 2025-07-24, IT: 2025-07-21, BG: 2025-07-23, DK: 2025-07-21, RO: 2025-07-23, HU: 2025-07-18, CZ: 2025-07-21, NL: 2025-09-03, ES: 2025-07-22, SK: 2025-07-18, BE: 2025-07-18, PL: 2025-07-23

Condition(s): Heart failure
Product: BI 690517, EMPAGLIFLOZIN, Placebo matching vicadrostat

Primary endpoint: The composite primary endpoint addressing the primary objective is as follows: Time to first event of • Cardiovascular (CV) death; or • Hospitalisation for heart failure (HHF); or • Urgent heart failure (HF) visit
Endpoint(s): Time to first event of cardiovascular death or HHF, Occurrences of HHF (first and recurrent), Absolute change from baseline in Kansas City Cardiomyopathy Questionnaire-Total Symptom Score (KCCQ-TSS) at Week 32

Source: https://euclinicaltrials.eu/ctis-public/view/2024-519525-38-00